EU clinical trial 2022-501316-34-00: PREDOSTAR - PREventing second cancers with DOSTARlimab - A multicenter, open-label, randomized phase II study aiming to assess the clinical impact of dostarlimab on occurrence of second primary cancer in patients with cured primary cancer
Protocol code: PREDOSTAR/ET22-215
Sponsor: Centre Leon Berard (Hospital/Clinic/Other health care facility). Phase: Therapeutic exploratory (Phase II). Countries: France (temporarily halted).
Therapeutic area(s): Diseases [C] - Neoplasms [C04]; Not possible to specify
Gender: Female, Male. Age: 18-64 years, 65+ years. Enrolment: 400.
Status: Temporarily halted. Start date (EU): 2023-11-27. Decision date: 2023-03-21. Results received: No. Last updated: 2026-03-12.

Condition(s): Patient cured from a primary cancer and at risk of 2nd cancer
Product: JEMPERLI 500 mg concentrate for solution for infusion

Primary endpoint: Incidence of SPC in patients who have completed curative treatment for a FPC., Second primary invasive cancer must be histologically confirmed and classified according to International Classification of Diseases for Oncology (https://www.who.int/classifications/icd/adaptations/oncology/en/) and IARC rules (REF).
Endpoint(s): • Rate of SPC at 3 years • Time to SPC • Event Free survival • Overall Survival since randomisation and since SPC • Recurrence of FPC, • AE/SAE according to NCI-CTCAE V5.0, Exploratory endpoint: Molecular profiles of new cancer and immune infiltrate characterisation, Exploratory endpoint: Blood immune cell functions, T/B cell response against shared tumour antigens, genetic abnormality in blood cells, immune cell infiltrates, shared tumour antigens), Exploratory endpoint: Exploration of potential biomarkers for early screening cancer in at-risk individuals

Source: https://euclinicaltrials.eu/ctis-public/view/2022-501316-34-00